EU clinical trial 2024-518803-23-00: Anticoagulant medicines for Balloon Pulmonary Angioplasty
Sponsor: St. Antonius Ziekenhuis (Hospital/Clinic/Other health care facility). Phase: Therapeutic use (Phase IV). Countries: Netherlands (ongoing, recruitment ended).
Therapeutic area(s): Diseases [C] - Pathological Conditions, Signs and Symptoms [C23]
Gender: Female, Male. Age: 18-64 years, 65+ years. Enrolment: 84.
Status: Ongoing, recruitment ended. Start date (EU): 2024-11-15. Decision date: 2024-11-15. Results received: No. Last updated: 2024-12-03.

Condition(s): Chronic Thromboembolic Pulmonary Hypertension (CTEPH), Chronic Thromboembolic Disease (CTED) without Pulmonary Hypertension
Product: Lixiana 60 mg film-coated tablets, Pradaxa 75 mg hard capsules, Acenocoumarol CF 1 mg, tabletten, Fenprocoumon Sandoz 3 mg, tabletten, Xarelto 2.5 mg film-coated tablets, Eliquis 2.5 mg film-coated tablets, Lixiana 30 mg film-coated tablets, Lixiana 15 mg film-coated tablets

Primary endpoint: Combination of periprocedural bleeding (life-threatening or disabling bleeding, vascular injury or access site problems) based on the international criteria (PH-symposium, VARC and BARC [2-3 and 5]) or lung injury (radiographic opacity with/without haemoptysis, with/without hypoxaemia) within 24 hours after BPA, on a per-session basis.
Endpoint(s): Individual items of the combined primary endpoint (on a per-session basis)., Procedure related endpoints (on a per-session basis): 1) Allergic reaction to contrast (assessed for total complication rate, not for VKA vs DOAC). 2) Renal dysfunction, Venous thromboembolism., Long-term bleeding complications based on international criteria., All-cause mortality., Non-scheduled hospitalization.

Source: https://euclinicaltrials.eu/ctis-public/view/2024-518803-23-00